EU clinical trial 2024-518831-12-00: Phase 1 trial of LAVA-1266, a CD123-targeting bispecific Vγ9Vδ2-T cell engager, in patients with CD123 positive relapsed/refractory (R/R) acute myeloid leukemia (AML) and intermediate risk, high risk, or extremely high-risk myelodysplastic syndrome (MDS)
Protocol code: LAVA1266-001
Sponsor: LAVA Therapeutics N.V. (Pharmaceutical company). Phase: Human Pharmacology (Phase I)- First administration to humans. Countries: Spain (ended).
Therapeutic area(s): Diseases [C] - Neoplasms [C04]
Gender: Female, Male. Age: 18-64 years, 65+ years. Enrolment: 20.
Status: Ended. Start date (EU): 2025-04-15. End date (EU): 2025-08-04. End date: 2025-08-05. Decision date: 2025-03-19. Results received: No. Last updated: 2025-04-02.

Condition(s): CD123 positive R/R AML and intermediate risk, high risk, or extremely high risk MDS.

Source: https://euclinicaltrials.eu/ctis-public/view/2024-518831-12-00